EU clinical trial 2024-517396-20-00: Phase 1 (sequential)/2a (parallel), double-blind, multicenter, randomized, controlled study to evaluate the safety and immunogenicity of two administrations of OVX033 sarbecovirus candidate vaccine, given intramuscularly (IM) at one-month interval, at three dose levels, in comparison to placebo, in subjects aged 18 years and older
Protocol code: OVX033-002
Sponsor: Osivax (Pharmaceutical company). Phase: Phase I and Phase II (Integrated)- Other. Countries: France (authorised, recruitment pending).
Therapeutic area(s): Diseases [C] - Virus Diseases [C02]
Gender: Female, Male. Age: 18-64 years, 65+ years. Enrolment: 240.
Status: Authorised, recruitment pending. Decision date: 2025-01-24. Results received: No. Last updated: 2025-01-24.

Condition(s): Sarbecoviruses disease
Product: OVX033, CHLORURE DE SODIUM 0,9 % B. BRAUN, solution pour perfusion

Primary endpoint: Phase 1 • Number and percentage of subjects reporting solicited local and systemic symptoms during 7 days after each administration in each cohort/group., Pase 1 • Number and percentage of doses followed by the reporting of solicited local and systemic symptoms during 7 days after each administration in each cohort/group., Phase 1 • Number and percentage of subjects reporting unsolicited AEs during 29 days after each administration in each cohort/group., Phase 1 • Number and percentage of doses followed by the reporting of unsolicited AEs during 29 days after each administration in each cohort/group., Phase 1 • Number and percentage of subjects reporting COVID-19 symptoms and laboratory-confirmed SARS-CoV-2 and/or influenza cases during the entire study duration in each cohort/group., Phase 1 • Number and percentage of subjects reporting AESI during the entire study duration in each cohort/group., Phase 1 • Number and percentage of subjects reporting MAAEs during the entire study duration in each cohort/group., Phase 1 • Number and percentage of subjects reporting SAEs during the entire study duration in each cohort/group., Phase 2a • Same reactogenicity and safety endpoints as in Phase 1., Phase 2a • Cell-mediated immune response to OVX033 after 1st and 2nd administrations at three dose levels (100µg, 250µg and 500µg) in terms of change of NP-specific SFUs per million PBMCs, measured by IFNγ ELISPOT, at Day 8/Day 36/Day 57 versus pre-1st injection baseline (Day 1) or/and pre-2nd injection (Day 29) in each cohort/group.
Endpoint(s): Phase 1 • Cell-mediated immune response to OVX033 after 1st and 2nd administrations at three dose levels (100µg, 250µg and 500µg) in terms of change of NP-specific SFUs per million PBMCs, measured by IFNγ ELISPOT, at Day 8/Day 36/Day 57 versus pre-1st injection baseline (Day 1) or/and pre-2nd injection (Day 29) in each cohort/group., Phase 1 • NP-specific CD4+ and CD8+T-cell frequencies measured by flow cytometry (on PBMCs) as expressing IL-2, TNFα and/or IFNγ upon in vitro stimulation at Day 8/Day 36/Day 57 versus pre-1st injection baseline (Day 1) or/and pre-2nd injection (Day 29) in a subset or in all subjects depending on the response measured in the ELISPOT assay., Phase 1 • Geometric mean titers (GMTs) of anti-nucleocapsid (N) Immunoglobulin G (IgG) (ELISA, serum) at Day 29/Day 57 versus pre-1st injection baseline (Day 1) or/and pre-2nd injection (Day 29) in each cohort/group., Phase 1 • Number and percentage of subjects with an increase (two-fold or four-fold) in anti-N IgG (ELISA, serum) titer at Day 29/Day 57 versus pre-1st injection baseline (Day 1) or/and pre-2nd injection (Day 29) in each cohort/group., Phase 1 • Persistence of the cell-mediated and humoral immune responses to OVX033 at Month 6 (5 months after the 2nd administration). The CMI response at Day 180 will be assessed in all subjects using IFNγ ELISPOT. The percentage of CD4+ and CD8+ T-cells will be evaluated using intracellular staining (ICS), in a subset or in all subjects depending on the response measured in the ELISPOT assay., Phase 1 • Geometric mean titers (GMTs) of anti-OVX313 IgG (ELISA, serum) at Day 29/Day 57 versus pre-1st injection baseline (Day 1) or pre-2nd injection (Day 29) in each cohort/group., Phase 1 • Anti-C4bp (C4b-binding protein) oligomerization domain IgG level (ELISA, serum) in subjects presenting a significant increase in the anti-OVX313 IgG., Phase 2a • Same as secondary endpoints/estimands of Phase 1 (except ELISPOT response which is a primary endpoint/estimand in Phase 2a).

Source: https://euclinicaltrials.eu/ctis-public/view/2024-517396-20-00